EU clinical trial 2024-513558-30-00: Optimizing the time of day of influenza vaccine administration in adults aged 60-85 years: A randomized controlled trial
Protocol code: IIV-654
Sponsor: Rijksinstituut voor Volksgezondheid en Milieu (RIVM) (Hospital/Clinic/Other health care facility). Phase: Therapeutic use (Phase IV). Countries: Netherlands (ended).
Therapeutic area(s): Diseases [C] - Respiratory Tract Diseases [C08]; Diseases [C] - Virus Diseases [C02]
Gender: Female, Male. Age: 18-64 years, 65+ years. Enrolment: 440.
Status: Ended. Start date (EU): 2024-09-25. End date (EU): 2025-05-01. Decision date: 2024-08-15. Results received: Yes. Last updated: 2024-09-12.

Condition(s): Influenza
Product: PNEUMOVAX 23 solution for injection in pre-filled syringe Pneumococcal Polysaccharide Vaccine, Vaxigrip Tetra, suspension for injection in pre-filled syringe Quadrivalent influenza vaccine (split virion, inactivated), Influvac Tetra suspension for injection in pre-filled syringe (influenza vaccine, surface antigen, inactivated)

Primary endpoint: The increase in influenza vaccine strain-specific serum antibody titers from pre-vaccination (T0) to 28 days (+/- 3 days) post-vaccination (T1) as measured by HI assay.
Endpoint(s): The increase in influenza-specific T cell responses in PBMCs from pre-vaccination (T0) to 28 days (+/- 3 days) post-vaccination (T1) as measured by ELISpot., Chronotype, assessed via the micro-Munich Chronotype Questionnaire, The incidence of influenza virus infection, as determined by rapid influenza diagnostic self-tests, and self-reported influenza-like illness symptoms up to six months of follow-up.

Source: https://euclinicaltrials.eu/ctis-public/view/2024-513558-30-00